EU clinical trial 2023-505379-61-00: HOVON 171 AML: A single arm phase II trial to assess cobicistat boosted venetoclax in combination with azacitidine in patients with newly diagnosed acute myeloid leukaemia (AML) who are not considered candidates for intensive treatment regimens
Protocol code: HO171
Sponsor: Haemato Oncology Foundation For Adults Netherlands (Hospital/Clinic/Other health care facility). Phase: Therapeutic exploratory (Phase II). Countries: Netherlands (ongoing, recruiting).
Therapeutic area(s): Diseases [C] - Neoplasms [C04]
Gender: Female, Male. Age: 18-64 years, 65+ years. Enrolment: 142.
Status: Ongoing, recruiting. Start date (EU): 2024-01-17. Decision date: 2023-10-25. Results received: No. Last updated: 2026-01-13.

Condition(s): Acute Myeloid Leukaemia
Product: VENETOCLAX, VENETOCLAX, COBICISTAT, VENETOCLAX, AZACITIDINE

Primary endpoint: Run-in phase: Pharmacokinetic equivalence of cobicistat boosted venetoclax and unboosted venetoclax (PK cycle 1 vs PK cycle 2)., Extension phase: Overall survival (OS)
Endpoint(s): Run-in phase: Venetoclax and cobicistat CL, Cmax, Tmax, Cmin and AUC0-24., Extension phase: Response rate (CR, CRi, CR/CRi, CRh, CR/CRh, CRMRD-, CR/CRiMRD-, CR/CRhMRD-, and MLFS)., Event free survival (EFS)., Relapse-free survival (RFS)., Incidence and severity of adverse events according to CTCAE version 5.0., Early (30-day and 60-day) mortality (in general, non-leukemic)., Time to next cycle, defined as the time from the start of the cycle until the start of the next cycle., OS of AZA/VEN/COBI treated patients in comparison with a real-world data cohort treated during the same time period and monitored by the Dutch Cancer registry., Prognostic/predictive impact of disease-associated genetic changes at diagnosis., Relapse-associated genetic changes (determined at relapse)., Clonal evolution during treatment., Exposure-response and exposure-toxicity relation of venetoclax in patients with AML., Cost-savings on venetoclax drug costs., Adherence to venetoclax and cobicistat.

Source: https://euclinicaltrials.eu/ctis-public/view/2023-505379-61-00